EU clinical trial 2023-508531-30-00: A randomized and controlled phase II protocol in non NF1 pediatric and AYA (Adolescent and Young Adults) patients bearing a newly diagnosed low grade glioma with wild type BRAF gene comparing a daily oral MEK inhibitor (Trametinib) versus weekly vinblastine for 18 months. PLGG – MEKTRIC (Pediatric Low Grade Glioma – MEKinhibitor TRIal vs Chemotherapy)
Protocol code: 7830
Sponsor: Les Hopitaux Universitaires De Strasbourg (Hospital/Clinic/Other health care facility). Phase: Therapeutic exploratory (Phase II). Countries: France (ongoing, recruiting).
Therapeutic area(s): Diseases [C] - Neoplasms [C04]
Gender: Female, Male. Age: 0-17 years, 18-64 years. Enrolment: 134.
Status: Ongoing, recruiting. Start date (EU): 2024-03-25. Decision date: 2024-03-25. Results received: No. Last updated: 2026-05-18.

Condition(s): grade 1 glioma/mixed glio-neuronal tumors or pleomorphic xanthoastrocytoma (PXA)
Product: Spexotras 0.05 mg/ml powder for oral solution, Mekinist 0.5 mg film-coated tablets, Mekinist 2 mg film-coated tablets, VELBE 10 mg, poudre pour solution injectable I.V., TRAMETINIB

Primary endpoint: Therefore, our primary endpoint is the 3-year PFS rates comparing the two arms (standard vs experimental). The analysis will be based on PFS measured from time of 1st treatment administration up to the first event during the first 3 years of follow-up. An event is defined as death for all reasons, progression of a residual tumor, reappearance of a tumor in case of disappearance and/or appearance of new locations in the brain and spine.
Endpoint(s): • the tumor response at 24 and 72 weeks based on the international and recognized RANO criteria, the analysis comparing the 2 arms will be based on overall response rate (ORR) by central independent radiological review assessment. The analysis will be conducted in all patients at least at 24 weeks of completed treatment or earlier for the patients who have discontinued for progression reasons. The tumor response will classify the patients in 2 groups: PD subgroup versus CR/PR/SD subgroup., • the 3-year OS rate: the OS calculation will take into account the survival measured from time of 1st treatment administration up to death., • the frequency and description of AE (adverse event)/SAE (serious adverse event) based on CTCAE criteria (using NCI-CTCAE version 5.0) focusing on visual disturbances, skin, intestinal and cardiac side effects in the experimental arm compared with the standard control arm. The safety assessment will be done by cycle and by patient., • the QoL based on specific questionnaires (PEDs-QoL) at baseline, 24 weeks, at the end of treatment and 3 years after the first treatment administration. The analysis is based on EORTC adapted QOL questionnaires., • the 3-year PFS and OS rates according to molecular biomarkers obtained with routinely done molecular analyses (RENOCLIP-LOC platform) and after centralized review of each tumor histology., • the 3-year PFS and OS rates according to visual outcome in patient with optic pathway glioma with an analysis of visual function (LoqMAR scale) at baseline, at 24 weeks, at the end of treatment and after 3 years of treatment., • the data of patients benefiting from the crossover strategy will be collected to obtain information about response rate, PFS and OS for those patients progressing or relapsing on standard arm treatment.

Source: https://euclinicaltrials.eu/ctis-public/view/2023-508531-30-00